EU clinical trial 2023-504331-41-00: A randomized, double-blind, placebo-controlled, parallel group study to assess the efficacy and long-term safety of dupilumab in children 2 to <6 years of age with uncontrolled asthma and/or recurrent severe asthmatic wheeze
Protocol code: EFC14771
Sponsor: Sanofi-Aventis Research & Development (Pharmaceutical company). Phase: Therapeutic confirmatory (Phase III). Countries: Poland (ongoing, recruitment ended), Hungary (ongoing, recruitment ended), Czechia (ongoing, recruitment ended), Netherlands (ended), Greece (ongoing, recruitment ended), Italy (ongoing, recruitment ended), Germany (ongoing, recruitment ended), Spain (ongoing, recruitment ended), France (ongoing, recruitment ended).
Therapeutic area(s): Diseases [C] - Respiratory Tract Diseases [C08]
Gender: Female, Male. Age: 0-17 years. Enrolment: 69.
Start date (EU): 2024-08-02. Decision date: 2023-12-06. Results received: No. Last updated: 2025-07-17.
Decision dates by country: FR: 2023-12-11, DE: 2023-12-08, GR: 2023-12-11, HU: 2023-12-07, IT: 2023-12-11, ES: 2023-12-11, NL: 2023-12-07, PL: 2023-12-06, CZ: 2023-12-07

Condition(s): Respiratory tract diseases - Wheezing, Asthma
Product: FLUTICASONE, Dupilumab, SALBUTAMOL, BUDESONIDE, MONTELUKAST, Matched placebo for test (dupilumab low dose), Matched placebo for test (dupilumab high dose), BECLOMETASONE, Dupilumab, SALMETEROL AND FLUTICASONE

Primary endpoint: Part A: Annualized rate of severe asthma exacerbations during the 52-week treatment period., Part B: Incidence of treatment-emergent adverse events (TEAEs), serious adverse events (SAEs), adverse events of special interest (AESIs), and AEs leading to permanent treatment discontinuation
Endpoint(s): Part A: Annualized rate of hospitalization, ER or urgent care visit for asthma exacerbation during the 52 week treatment period., Part A: Annualized rate of moderate asthma exacerbations during the 52-week treatment period, Part A: Cumulative ICS dose during the 52-week treatment period, Part A: Change from baseline in weekly average use of reliever medication during the 52-week treatment period, Part A: Mean number of days without asthma symptoms (DWAS) using the Pediatric Asthma Caregiver Diary (PACD) during the 52-week treatment period, Part A: Change from baseline to Week 52 in daytime symptom score using the daytime record of PACD, Part A: Incidence of TEAEs, SAEs, AESIs, and AEs leading to permanent treatment discontinuation, Part A: Change from baseline to Week 52 in Pediatric Quality of Life Inventory (PedsQL) 4.0 Generic Scale, Part A: Caregiver Global Impression of Change in their child’s asthma control (CGI-change in asthma control) at Week 52, Part A: Physician Global Assessment of Change of the child’s asthma control (PGA-change in asthma control) at Week 52, Part A: Change from baseline to Week 52 in Caregiver Global Impression of their child’s asthma control (CGI-asthma control), Part A: Change from baseline to Week 52 in Caregiver Global Impression of their child’s asthma severity (CGI-asthma severity), Part A: Change from baseline to Week 52 in Physician Global Assessment of the child’s asthma control (PGA-asthma control)., Part A: Change from baseline to Week 52 in Test for Respiratory and Asthma Control in Kids (TRACK), Part A: Change from baseline in blood eosinophil level at Weeks 24 and 52, Part A: Concentration of dupilumab in serum over time during the 52-week treatment period, Part A: Incidence of treatment-emergent anti-drug antibody (ADA) against dupilumab over time, Part A: IgG response to any vaccination for tetanus, diphtheria and pertussis and antibody for influenza (HAI antibody titers) vaccine administered according to vaccination schedule during the 52-week treatment period, Part B: Annualized rate of severe asthma exacerbations events during the 52-week Part B treatment period, Part B Concentration of dupilumab in serum over time during the 52-week Part B treatment period, Part B: Incidence of treatment-emergent anti-drug antibodies (ADAs) against dupilumab over time

Source: https://euclinicaltrials.eu/ctis-public/view/2023-504331-41-00